EU clinical trial 2023-506613-22-00: The One-Month DAPT with Ticagrelor In CABG PatieNts Trial (ODIN)
Protocol code: ODIN
Sponsor: Weill Medical College Of Cornell University (Hospital/Clinic/Other health care facility). Phase: Therapeutic confirmatory (Phase III). Countries: Germany (ongoing, recruiting), Austria (ongoing, recruiting), Sweden (ongoing, recruiting).
Therapeutic area(s): Diseases [C] - Cardiovascular Diseases [C14]
Gender: Female, Male. Age: 18-64 years, 65+ years. Enrolment: 300.
Status: Ongoing, recruiting. Start date (EU): 2024-09-25. Decision date: 2024-09-25. Results received: No. Last updated: 2026-01-19.
Decision dates by country: SE: 2024-09-26, AT: 2024-09-29, DE: 2024-09-25

Condition(s): coronary artery disease
Product: Aspirin® protect 100 mg Magensaftresistente Tablette Acetylsalicylsäure, Brilique 90 mg film-coated tablets, Thrombo ASS 100 mg-Filmtabletten, Trombyl 75 mg tabletter

Primary endpoint: The hierarchical composite of time to death, stroke, myocardial infarction, repeat revascularization and any graft failure assessed at 1 year.
Endpoint(s): The hierarchical composite of time to death, stroke, myocardial infarction, Bleeding Academic Research consortium (BARC) type 3 bleeding, repeat revascularization and any graft failure assessed at 1 year., The hierarchical composite of time to death, stroke, myocardial infarction, repeat revascularization and 5-year time-averaged disease-specific (Seattle Angina Questionnaire [SAQ]-7) quality of life (QoL) score assessed at 5 years., The hierarchical composite of time to death, stroke, myocardial infarction, BARC type 3 bleeding, repeat revascularization and 5-year time-averaged SAQ-7 QoL score assessed at 5 years.

Source: https://euclinicaltrials.eu/ctis-public/view/2023-506613-22-00